EU clinical trial 2023-504360-42-00: Less Bleeding by Omitting Aspirin in Non-ST-segment Elevation Acute Coronary Syndrome Patients
Sponsor: Amsterdam UMC (Hospital/Clinic/Other health care facility). Phase: Therapeutic use (Phase IV). Countries: Netherlands (ongoing, recruitment ended), Belgium (ongoing, recruitment ended).
Therapeutic area(s): Diseases [C] - Cardiovascular Diseases [C14]; Analytical, Diagnostic and Therapeutic Techniques and Equipment [E] - Therapeutics [E02]
Gender: Female, Male. Age: 18-64 years, 65+ years. Enrolment: 3090.
Status: Ongoing, recruitment ended. Start date (EU): 2022-05-13. Decision date: 2023-04-03. Results received: No. Last updated: 2026-06-19.
Decision dates by country: BE: 2023-10-19, NL: 2023-04-03

Condition(s): Non-ST-segment elevation acute coronary syndrome
Product: Acetylsalicylzuur Cardio Aurobindo 80 mg, dispergeerbare tabletten.

Primary endpoint: Major or minor bleeding defined as Bleeding Academic Research Consortium (BARC) type 2, 3 or 5 bleeding at 12 months, Composite of all-cause mortality, myocardial infarction, and stroke at 12 months

Source: https://euclinicaltrials.eu/ctis-public/view/2023-504360-42-00